EU clinical trial 2023-509709-63-00: A Phase IIb, Multicentre, Randomised, Double-Blind, Dose-finding Study to Evaluate the Efficacy, Safety and Tolerability of Balcinrenone in Combination with Dapagliflozin Compared with Dapagliflozin in Patients with Chronic Kidney Disease and Albuminuria
Protocol code: D6405C00002
Sponsor: AstraZeneca AB (Pharmaceutical company). Phase: Therapeutic exploratory (Phase II). Countries: Bulgaria (ended), Austria (ended), Italy (ended), Poland (ended), Spain (ended).
Therapeutic area(s): Phenomena and Processes [G] - Metabolism [G03]
Gender: Female, Male. Age: 18-64 years, 65+ years. Enrolment: 85.
Status: Ended. Start date (EU): 2024-07-30. End date (EU): 2025-05-09. End date: 2025-05-10. Decision date: 2024-07-09. Results received: Yes. Last updated: 2025-04-23.
Decision dates by country: BG: 2024-07-15, IT: 2024-07-09, AT: 2024-07-15, PL: 2024-07-15, ES: 2024-07-11

Condition(s): Chronic Kidney Disease and Albuminuria
Product: Forxiga 10 mg film-coated tablets, Balcinrenone+Dapagliflozin, Balcinrenone+Dapagliflozin, Balcinrenone+Dapagliflozin, Forxiga

Primary endpoint: Relative change in UACR from baseline to Week 12

Source: https://euclinicaltrials.eu/ctis-public/view/2023-509709-63-00